EU clinical trial 2023-506195-27-00: A Phase 3, Randomized, Placebo-Controlled, Double-Blind Study to Evaluate the Efficacy, Safety, and Tolerability of Upadacitinib in Adult and Adolescent Subjects with Non-Segmental Vitiligo Who Are Eligible for Systemic Therapy
Protocol code: M19-044
Sponsor: AbbVie Deutschland GmbH & Co. KG (Pharmaceutical company). Phase: Therapeutic confirmatory (Phase III). Countries: Germany (ongoing, recruitment ended), Spain (ongoing, recruitment ended), Bulgaria (ongoing, recruitment ended), Poland (ongoing, recruitment ended), France (ongoing, recruitment ended), Italy (ongoing, recruitment ended), Portugal (ongoing, recruitment ended), Belgium (ongoing, recruitment ended), Netherlands (ongoing, recruitment ended), Hungary (ended), Slovakia (ongoing, recruitment ended).
Therapeutic area(s): Diseases [C] - Immune System Diseases [C20]
Gender: Female, Male. Age: 0-17 years, 18-64 years, 65+ years. Enrolment: 239.
Start date (EU): 2024-04-05. Decision date: 2024-03-26. Results received: No. Last updated: 2026-07-29.
Decision dates by country: HU: 2024-06-06, IT: 2024-04-02, BG: 2024-04-01, NL: 2024-04-02, PL: 2024-04-02, ES: 2024-04-17, FR: 2024-03-28, PT: 2024-03-27, BE: 2024-03-28, SK: 2024-03-26, DE: 2024-03-26

Condition(s): non-segmental vitiligo
Product: Upadacitinib, Upadacitinib Placebo, Upadacitinib

Primary endpoint: Achievement of T-VASI 50 (≥ 50% reduction in T-VASI from Baseline) at Week 48, Achievement of F-VASI 75 (≥ 75% reduction in F-VASI from Baseline) at Week 48
Endpoint(s): Achievement of F-VASI 50 (≥ 50% reduction in F-VASI from Baseline) at Week 48;, Achievement of F-VASI 75 (≥ 75% reduction in F-VASI from Baseline) at Week 24;, Percent change from Baseline in F-VASI at Week 24;, Percent change from Baseline in T-VASI at Week 48;, Achievement of F-VASI 90 (≥ 90% reduction in F-VASI from Baseline) at Week 48;, Achievement of VNS score of "A lot less noticeable (4)" or "No longer noticeable (5)" at Week 48;, Achievement of PaGIC-V of "Much better (1)" at Week 48., Achievement of PhGIC-V of "Much better (1)" at Week 48;

Source: https://euclinicaltrials.eu/ctis-public/view/2023-506195-27-00